EU clinical trial 2022-500870-32-02: Evaluation of the effectiveness of the reconsolidation therapy in a clinical population suffering from post-traumatic stress disorder
Protocol code: ULB-PTSD-Propranolol
Sponsor: Hopital Erasme (Hospital/Clinic/Other health care facility). Phase: Therapeutic exploratory (Phase II). Countries: Belgium (ongoing, recruiting).
Therapeutic area(s): Psychiatry and Psychology [F] - Behavior and Behavior Mechanisms [F01]; Psychiatry and Psychology [F] - Psychological Phenomena [F02]; Psychiatry and Psychology [F] - Behavioral Disciplines and Activities [F04]; Psychiatry and Psychology [F] - Mental Disorders [F03]
Gender: Female, Male. Age: 18-64 years, 65+ years. Enrolment: 68.
Status: Ongoing, recruiting. Start date (EU): 2023-10-04. Decision date: 2023-02-28. Results received: No. Last updated: 2023-06-06.

Condition(s): Post-traumatic stress disorder
Product: Inderal 10 mg film-coated tablets., Inderal 40 mg film-coated tablets.

Primary endpoint: PCL-S: Posttraumatic stress disorder Checklist Scale.
Endpoint(s): PANAS: Positive And Negative Affect Schedule., HADs: Hospital Anxiety and Depression scale., DERS: Difficulties in Emotion Regulation Scale., HRV: Heart Rate Variability by a clock Polar V800.

Source: https://euclinicaltrials.eu/ctis-public/view/2022-500870-32-02